EU clinical trial 2023-509563-24-00: A Phase 3, Open-label Study Evaluating the Long term Safety and Efficacy of Elexacaftor/Tezacaftor/Ivacaftor in Cystic Fibrosis Subjects 12 Months of Age and Older
Protocol code: VX22-445-123
Sponsor: Vertex Pharmaceuticals Inc. (Pharmaceutical company). Phase: Therapeutic confirmatory (Phase III). Countries: Denmark (ongoing, recruitment ended), Netherlands (ongoing, recruitment ended), Germany (ongoing, recruitment ended).
Therapeutic area(s): Diseases [C] - Respiratory Tract Diseases [C08]
Gender: Female, Male. Age: 0-17 years. Enrolment: 15.
Status: Ongoing, recruitment ended. Start date (EU): 2025-01-08. Decision date: 2024-10-21. Results received: No. Last updated: 2025-08-19.
Decision dates by country: DK: 2024-10-21, NL: 2024-11-21, DE: 2024-11-05

Condition(s): Cystic Fibrosis
Product: VX-445/VX-661/VX-770 fixed-dose combination granules, VX-770 75mg, VX-770 granules, Kaftrio 75 mg/50 mg/100 mg granules in sachet, Kalydeco 50 mg granules in sachet, VX-445/VX-661/VX-770 fixed-dose combination granules, Kaftrio 60 mg/40 mg/80 mg granules in sachet, VX-770 50mg, Kalydeco 59.5 mg granules in sachet, Kalydeco 25 mg granules in sachet, Kalydeco 75 mg granules in sachet, VX-445/VX-661/VX-770 granules, VX-445/VX-661/VX-770 granules, Ivacaftor 25 mg granules

Primary endpoint: Safety and tolerability assessments as determined by adverse events (AEs), clinical laboratory values, standard 12-lead ECGs, vital signs, and pulse oximetry
Endpoint(s): Absolute change in sweat chloride (SwCl)

Source: https://euclinicaltrials.eu/ctis-public/view/2023-509563-24-00